EU clinical trial 2024-518581-27-00: A Study to evaluate the effect of a high-fat meal on the Pharmacokinetics of the Selective MET kinase Inhibitor DO-2 in subjects in good health
Sponsor: DeuterOncology (Pharmaceutical company). Phase: Human Pharmacology (Phase I)- Other. Countries: Netherlands (ended).
Therapeutic area(s): Not possible to specify
Gender: Female, Male. Age: 18-64 years. Enrolment: 12.
Status: Ended. Start date (EU): 2024-12-12. End date (EU): 2025-07-08. Decision date: 2024-11-25. Results received: No. Last updated: 2025-05-19.

Condition(s): Healthy volunteer

Source: https://euclinicaltrials.eu/ctis-public/view/2024-518581-27-00